EU clinical trial 2025-522710-22-00: MetAddon: Methadone as co-analgesic for patients with metastatic bone pain: a double-blind randomized controlled trial
Sponsor: Universiteit Maastricht (Educational Institution). Phase: Therapeutic use (Phase IV). Countries: Netherlands (ongoing, recruiting).
Therapeutic area(s): Diseases [C] - Neoplasms [C04]; Diseases [C] - Pathological Conditions, Signs and Symptoms [C23]
Gender: Female, Male. Age: 18-64 years, 65+ years. Enrolment: 166.
Status: Ongoing, recruiting. Start date (EU): 2026-05-28. Decision date: 2025-10-20. Results received: No. Last updated: 2026-04-15.

Condition(s): Cancer, bone metastasis, pain
Product: Methadon, Morphine sulfate

Primary endpoint: Difference in proportion of patients with ≥ 30% reduction in mean pain between both groups based on average scores of day 5, 6 and 7 using an 11-point scale.
Endpoint(s): Mean and worst pain intensity after each week using an 11-point scale., Time in days between start study medication andreaching ≥ 30% reduction in mean pain score., Mean pain intesity using 11-point scale on day 21 compared to mean pain inensity at baseline., Global perceibed effect after three weeks., Frequency use of rescue medication throughout the study, Self-reported side effects on day 1, 7, 8, 14 and 21 using medcation and pain diary on an 7-point scale and complications via (S)AE reports., Health-related quality of life at baseline and after 7, 14 and 21 days using EQ-5D-5L and FACT-BP questionnaires., Health-care costs and cost-effectiveness at three weeks., Opioid increased ratio: difference in daily opioid dose on day 21 compared to baseline.

Source: https://euclinicaltrials.eu/ctis-public/view/2025-522710-22-00